EU clinical trial 2024-517382-17-00: A Phase 2 Study to Evaluate Safety and Efficacy of Teclistamab-,Talquetamab- and JNJ-79635322-based Combination Regimens in Participants with Newly Diagnosed Transplant Eligible Multiple Myeloma
Protocol code: GMMG-HD10/ DSMM XX
Sponsor: Universitaetsklinikum Heidelberg AöR (Hospital/Clinic/Other health care facility). Phase: Therapeutic exploratory (Phase II). Countries: Germany (ongoing, recruiting).
Therapeutic area(s): Diseases [C] - Hemic and Lymphatic Diseases [C15]
Gender: Female, Male. Age: 18-64 years, 65+ years. Enrolment: 130.
Status: Ongoing, recruiting. Start date (EU): 2022-11-30. Decision date: 2024-09-11. Results received: No. Last updated: 2026-02-11.

Condition(s): Newly Diagnosed Multiple Myeloma in patients eligible for stem cell transplantation
Product: Lenalidomid STADA 5 mg Hartkapseln, JNJ-64407564, Lenalidomid AL 15 mg Hartkapseln, Lenalidomid HEXAL 25 mg Hartkapseln, Lenalidomid AL 25 mg Hartkapseln, Lenalidomid HEXAL 15 mg Hartkapseln, Lenalidomid HEXAL 10 mg Hartkapseln, Lenalidomid HEXAL 5 mg Hartkapseln, JNJ-79635322, DARZALEX 1800 mg solution for injection, Lenalidomid STADA 15 mg Hartkapseln, teclistamab, teclistamab, VELCADE 3.5 mg powder for solution for injection, JNJ-79635322, Lenalidomid STADA 10 mg Hartkapseln, DEXAMETHASONE, Lenalidomid AL 5 mg Hartkapseln, Lenalidomid STADA 25 mg Hartkapseln, Lenalidomid AL 10 mg Hartkapseln, JNJ-64407564

Primary endpoint: The primary endpoints are incidence and severity of AEs and SAEs during treatment with teclistamab-, talquetamab-, and JNJ-79635322-based combination regimens for each arm.
Endpoint(s): Rate of MRD negative CR, defined as the proportion of participants who achieve MRD negative status as determined by NGF (and NGS if evaluated) with a sensitivity of 10-5, and achieve CR or better response post-induction (Arms A, A1, B, D, E, and E1, and G, and [if applicable] F and F1), post-ASCT (Arms A, A1, B, E, and E1, and [if applicable] F and F1), post Tec-Tal (Arm D), post-JNJ-79635322-D (Arm G), post-maintenance (Arms C, C1, and C2), and overall (all arms)., Rate of sustained MRD negative CR is defined as the proportion of participants who achieve MRD negative CR, confirmed for a minimum of 12 months apart and without any examination in between showing MRD-positive status, occurrence of PD, or start of subsequent anti-myeloma therapy, during the entire study treatment phase of each arm (all arms)., Rate of MRD negative CR conversion and deepening during maintenance (all arms except Arm D and Arm G), Tec-Tal treatment (Arm D), or JNJ-79635322-D treatment (Arm G)., Response rates post-induction treatment (Arms A, A1, B, D, E, E1, G, and, if applicable, F and F1), post-ASCT (Arms A, A1, B, E, E1, and, if applicable, F and F1), post-maintenance (Arms A, A1, B, E, E1, and, if applicable, F and F1), post Tec-Tal (Arm D), post-JNJ-79635322-D (Arm G), and overall: - ORR defined as the proportion of participants who achieve PR or better, according to the IMWG criteria, by the respective time point., - CR or better rate, defined as the proportion of participants who achieve CR or better, according to the IMWG criteria, by the respective time point., - VGPR or better rate is defined as the proportion of participants achieving VGPR or better, according to the IMWG criteria, by the respective time point., Response rates post-maintenance and overall (Arms C, C1, and C2) - CR or better rate., Arms A, A1, B, D, E, E1, G, and, if applicable, F and F1: Duration of response, defined as the duration from the date of initial documentation of a response (PR or better) according to the IMWG criteria (Appendix 5) to the date of first documented evidence of progressive disease according to the IMWG criteria (Appendix 5) or death due to any cause, whichever occurs first. Participants who have not progressed and are alive will be censored at the last disease evaluation before the start of subseq, Arms C, C1, and C2: Duration of response defined as the date from the first maintenance dose to the date of first documented evidence of progressive disease according to the IMWG criteria (Appendix 5) or death due to any cause, whichever occurs first. Participants who have not progressed and are alive will be censored at the last disease evaluation before the start of subsequent anti-myeloma therapy., PFS defined as the duration from the date of first dosing to the date of first documented evidence of progressive disease or death, whichever occurs first (all arms). Disease progression will be determined according to the IMWG criteria. For participants who have not progressed and are alive, data will be censored at the last disease assessment before the start of any subsequent anti-myeloma therapy. For participants who are lost to follow-up or who withdraw consent and who have not progressed b, Stem Cell Harvest (Arms A, A1, B, D, E, E1, G and [if applicable] F and F1) - Number (%) of participants who undergo stem cell mobilization (all above cohorts) and who undergo ASCT (except Arms D and G) will be summarized. Stem cell yield, the number of CD34+ cells transplanted, days to engraftment for neutrophils, and days to engraftment for platelets will be summarized by mean, standard deviation, median, minimum, and maximum.

Source: https://euclinicaltrials.eu/ctis-public/view/2024-517382-17-00